EU clinical trial 2024-514081-40-00: J4M-MC-PWMP: A Master Protocol for a Randomized, Controlled, Clinical Platform Trial to Investigate the Efficacy and Safety of Interventions for Chronic Weight Management in Pediatric Participants with Obesity or Overweight (ADVANCE); J4M-MC-PW01: Efficacy, Safety, and Pharmacokinetics of Orforglipron Once Daily Oral versus Placebo in Adolescent Participants Who Have Obesity, or Overweight with Weight-Related Comorbidities: A Randomized, Double-Blind Trial (ADVANCE-ATTAIN-ADOLESCENTS)
Protocol code: JAM-MC-PWMP, -PW01
Sponsor: Eli Lilly & Co. (Pharmaceutical company). Phase: Therapeutic confirmatory (Phase III). Countries: Poland (ongoing, recruiting), Italy (ongoing, recruitment ended).
Therapeutic area(s): Diseases [C] - Nutritional and Metabolic Diseases [C18]
Gender: Female, Male. Age: 0-17 years. Enrolment: 11.
Start date (EU): 2025-06-06. Decision date: 2025-03-12. Results received: No. Last updated: 2026-07-28.
Decision dates by country: IT: 2025-03-12, PL: 2025-03-16

Condition(s): Obesity, Overweight
Product: ORFORGLIPRON, ORFORGLIPRON, Placebo to match LY3502970, ORFORGLIPRON, ORFORGLIPRON, ORFORGLIPRON, Orforglipron

Primary endpoint: Percent Change from Baseline in Body Mass Index (BMI) [Time Frame: Baseline, Week 72]

Source: https://euclinicaltrials.eu/ctis-public/view/2024-514081-40-00